EU clinical trial 2024-516048-24-00: OPEN LABEL PHASE 2 STUDY ON THE EFFICACY AND TOLERANCE OF A COMBINATION OF PONATINIB AND 5-AZACITIDINE IN CHRONIC MYELOGENOUS LEUKAEMIA IN ACCELERATED PHASE OR IN MYELOID BLAST CRISIS
Protocol code: PONAZA_P16/23
Sponsor: Centre Hospitalier De Versailles (Hospital/Clinic/Other health care facility). Phase: Therapeutic exploratory (Phase II). Countries: France (ongoing, recruitment ended).
Therapeutic area(s): Diseases [C] - Hemic and Lymphatic Diseases [C15]
Gender: Female, Male. Age: 18-64 years, 65+ years. Enrolment: 40.
Status: Ongoing, recruitment ended. Start date (EU): 2019-06-19. Decision date: 2024-07-25. Results received: No. Last updated: 2026-01-05.

Condition(s): CHRONIC MYELOGENOUS LEUKAEMIA IN ACCELERATED PHASE OR IN MYELOID BLAST CRISIS
Product: Iclusig 15 mg film-coated tablets, AZACITIDINE ARROW 25 mg/mL, poudre pour suspension injectable

Primary endpoint: The primary endpoint is Overall Survival by 2 years
Endpoint(s): Adverse events - CTCAE Version 4.0, Cumulative rate of patients achieving CHR, Cumulative rate of patients achieving complete cytogenetic responses, Cumulative rate of patients achieving molecular responses, Cumulative rate of patients reverting to chronic phase CML, Analysis of clonal architecture, methylation profile, bcr-abl mutations and cytogenetics in blast crisis and AP at baseline, and in case of relapse or failure, Event free survival, duration of response, Number of patients allocated to allogenic transplant, Survival after transplant and post-transplantation relapse rate

Source: https://euclinicaltrials.eu/ctis-public/view/2024-516048-24-00